EU clinical trial 2023-509773-23-00: C4671026-A PHASE 2/3, INTERVENTIONAL SAFETY, PHARMACOKINETICS, AND EFFICACY, OPEN-LABEL, MULTI-CENTER, SINGLE-ARM STUDY TO INVESTIGATE ORALLY ADMINISTERED PF-07321332 (NIRMATRELVIR)/RITONAVIR IN NONHOSPITALIZED SYMPTOMATIC PEDIATRIC PARTICIPANTS WITH COVID-19 WHO ARE AT RISK OF PROGRESSION TO SEVERE DISEASE
Protocol code: C4671026
Sponsor: Pfizer Inc. (Pharmaceutical company). Phase: Phase II and Phase III (Integrated). Countries: Bulgaria (ongoing, recruitment ended), Hungary (ended).
Therapeutic area(s): Diseases [C] - Virus Diseases [C02]
Gender: Female, Male. Age: 0-17 years. Enrolment: 39.
Start date (EU): 2023-07-13. Decision date: 2024-05-14. Results received: No. Last updated: 2026-04-03.
Decision dates by country: HU: 2024-05-14, BG: 2024-05-14

Condition(s): SARS-CoV-2 Infection
Product: NIRMATRELVIR, NIRMATRELVIR, Ritonavir, nirmatrelvir / ritonavir

Primary endpoint: Plasma nirmatrelvir PK parameters including Cmax, AUC0-tau, t1/2, and Ctrough., Incidence of TEAEs, SAEs, AEs leading to discontinuations, and vital sign measurements
Endpoint(s): SARS-CoV-2 viral RNA measured via RT-PCR in nasopharyngeal or nasal swabs over time, Proportion of participants with COVID-19 related hospitalization or death from any cause through Day 28, Acceptability and palatability assessments of nirmatrelvir/ritonavir (filmcoated tablets and oral powder)

Source: https://euclinicaltrials.eu/ctis-public/view/2023-509773-23-00